EU clinical trial 2023-503869-34-00: A study testing increasing amounts (doses) of CC-91633 to find out what dose can be tolerated without serious side effects in patients with acute myeloid leukemia (AML) that has come back after treatment or cannot be cured or treated by any other known therapies, also called relapsed or refractory AML (R/R AML) and in patients with relapsed or refractory higher-risk myeloid dysplastic syndrome (R/R HR-MDS).
Protocol code: CC-91633-AML-001
Sponsor: Celgene Corp. (Pharmaceutical company). Phase: Human Pharmacology (Phase I)- First administration to humans. Countries: Spain (ended).
Therapeutic area(s): Diseases [C] - Neoplasms [C04]
Gender: Female, Male. Age: 18-64 years, 65+ years. Enrolment: 48.
Status: Ended. Start date (EU): 2022-03-15. End date (EU): 2025-06-04. End date: 2025-07-30. Decision date: 2023-03-13. Results received: No. Last updated: 2025-06-17.

Condition(s): Acute myeloid leukemia or myelodysplastic syndrome of high risk group, that has come back after treatment or cannot be cured or treated by any other known therapies.

Source: https://euclinicaltrials.eu/ctis-public/view/2023-503869-34-00